EU clinical trial 2024-519207-10-00: Ravulizumab dose optimization
Protocol code: 116326
Sponsor: Radboud universitair medisch centrum Stichting (Hospital/Clinic/Other health care facility). Phase: Therapeutic use (Phase IV). Countries: Netherlands (ongoing, recruiting).
Therapeutic area(s): Phenomena and Processes [G] - Immune system processes [G12]
Gender: Female, Male. Age: 18-64 years, 65+ years. Enrolment: 25.
Status: Ongoing, recruiting. Start date (EU): 2025-05-12. Decision date: 2025-02-17. Results received: No. Last updated: 2026-01-05.

Condition(s): Paroxysmal nocturnal hemoglobinuria (PNH)
Product: Ultomiris 300 mg/30 mL concentrate for solution for infusion

Primary endpoint: Percentage of change in LDH compared to baseline LDH between standard dosing and individualized dosing, Difference in percentage target attainment (Ravulizumab concentration >100 mg/L) between the standard dosing regimen and the individualized dosing regimen
Endpoint(s): The proportion of patients with breakthrough hemolysis, defined as at least 1 new or worsening symptom or sign of intravascular hemolysis (fatigue, hemoglobinuria, abdominal pain, shortness of breath [dyspnea], anemia [hemoglobin <10 g/dL], major adverse vascular event [including thrombosis], dysphagia, or erectile dysfunction) in the presence of elevated LDH ≥2× the ULN after prior reduction of LDH to <1.5× the ULN on treatment, Quality of life assessed with the FACIT-Fatigue Scale and patient preference, Differences between number of transfusions between both dosing strategies, Differences in cumulative ravulizumab dose over 52 weeks, number of infusions and appointments with the physician as surrogate marker for treatment costs.

Source: https://euclinicaltrials.eu/ctis-public/view/2024-519207-10-00